EU clinical trial 2024-514047-28-00: A Phase 3, Randomized, Open-Label, Active-Controlled Study to Evaluate a Switch to an Oral Weekly Islatravir/Lenacapavir Regimen in People With HIV-1 Who Are Virologically Suppressed on Standard of Care
Protocol code: GS-US-563-5926
Sponsor: Gilead Sciences Inc. (Pharmaceutical company). Phase: Therapeutic confirmatory (Phase III). Countries: Netherlands (ongoing, recruitment ended), Poland (ongoing, recruitment ended), Germany (ongoing, recruitment ended), Spain (ongoing, recruitment ended).
Therapeutic area(s): Diseases [C] - Virus Diseases [C02]
Gender: Female, Male. Age: 18-64 years, 65+ years. Enrolment: 76.
Status: Ongoing, recruitment ended. Start date (EU): 2025-01-27. Decision date: 2025-01-09. Results received: No. Last updated: 2026-07-20.
Decision dates by country: PL: 2025-01-10, NL: 2025-01-13, DE: 2025-01-09, ES: 2025-01-13

Condition(s): HIV-1 Infection
Product: ISLATRAVIR/LENACAPAVIR, LAMIVUDINE AND DOLUTEGRAVIR, DOLUTEGRAVIR, LAMIVUDINE AND ABACAVIR, RILPIVIRINE, EMTRICITABINE, TENOFOVIR ALAFENAMIDE AND BICTEGRAVIR, EMTRICITABINE AND TENOFOVIR ALAFENAMIDE, RITONAVIR, RALTEGRAVIR, DARUNAVIR, DARUNAVIR AND COBICISTAT, EMTRICITABINE, TENOFOVIR DISOPROXIL, ELVITEGRAVIR AND COBICISTAT, LAMIVUDINE, TENOFOVIR DISOPROXIL AND DORAVIRINE, TENOFOVIR DISOPROXIL AND EMTRICITABINE, TENOFOVIR ALAFENAMIDE, EMTRICITABINE, TENOFOVIR ALAFENAMIDE, ELVITEGRAVIR AND COBICISTAT, DORAVIRINE, COBICISTAT, EMTRICITABINE, EMTRICITABINE, TENOFOVIR ALAFENAMIDE, DARUNAVIR AND COBICISTAT, EMTRICITABINE, TENOFOVIR ALAFENAMIDE AND RILPIVIRINE, Viread 123 mg film-coated tablets, ISLATRAVIR/LENACAPAVIR, LAMIVUDINE, EMTRICITABINE, TENOFOVIR DISOPROXIL AND RILPIVIRINE, LAMIVUDINE, ABACAVIR AND DOLUTEGRAVIR

Primary endpoint: The proportion of participants with HIV-1 RNA ≥ 50 copies/mL at Week 48 as determined by the United States (US) Food and Drug Administration (FDA)-defined snapshot algorithm
Endpoint(s): Proportion of Participants with HIV-1 RNA ≥ 50 copies/mL at Week 96 as Determined by the US FDA-defined Snapshot Algorithm, Proportion of Participants with HIV-1 RNA < 50 copies/mL at Week 48 and 96 as Determined by the US FDA-defined Snapshot Algorithm, The change from baseline in CD4+ T-cell count at Weeks 48 and 96, The proportion of participants discontinuing ISL/LEN due to treatment-emergent adverse events (AEs)

Source: https://euclinicaltrials.eu/ctis-public/view/2024-514047-28-00